EU clinical trial 2024-518670-13-00: A randomized, controlled, double-blind clinical trial evaluating the effect of METformin treatment on endometrial function in women diagnosed with Idiopathic Infertility
Protocol code: 2021/ABM/03/00006
Sponsor: Medical University Of Bialystok (Educational Institution). Phase: Therapeutic exploratory (Phase II). Countries: Poland (ongoing, recruiting).
Therapeutic area(s): Diseases [C] - Female Urogenital Diseases and Pregnancy Complications [C13]
Gender: Female. Age: 18-64 years. Enrolment: 180.
Status: Ongoing, recruiting. Start date (EU): 2024-10-16. Decision date: 2024-12-13. Results received: No. Last updated: 2026-04-30.

Condition(s): idiopathic infertility
Product: Placebo, GLUCOPHAGE 500 mg tabletki powlekane

Primary endpoint: Obtaining a pregnancy during the study.
Endpoint(s): Evaluation of the effect of metformin therapy on endometrial function,assessed indirectly by blood tests of patients, will be examined by analyzing the concentrations of markers: cytokine(interleukin 1 and 2),insulin-like growth factor(IGF),leukemia inhibitory factor(LIF),transforming growth factor alpha(TGF-α),epidermal growth factor(EGF),heparin-binding growth factor-like EGF(HB-EGF),vascular endothelial growth factor(VEGF),histamine, inhibin B,relaxin and insulin receptor, Analysis of the transcriptome of endometrial tissues using next-generation sequencing (NGS) technology to assess the effectiveness of increasing pregnancy rates in the in vitro fertilization procedure. The study will examine the full transcriptome, including a detailed microRNA profile. This will allow us to assess whether microRNAs, as regulators of gene expression, can act as predictive markers indicating the effectiveness of the in vitro fertilization procedure., Intrauterine metabolomic profiling of steroids will be conducted to investigate whether metabolic analysis of these compounds can be used to identify potential prognostic markers. These markers could then be used to assess the effectiveness of increasing pregnancy rates in an in vitro fertilization procedure., Effect of metformin treatment on regulation of oxidative stress. Increased production of reactive oxygen species (ROS) can negatively affect the implantation process. Metformin stimulates antioxidant processes and reduces the synthesis of ROS, which may contribute to the chance of embryo implantation in in vitro fertilization., Analysis of the Quality of Life (QoL) questionnaire of patients undergoing the study and analysis of menus combined with DXA examination will provide key information to assess the impact of diet and lifestyle on the effectiveness of in vitro fertilization. The data collected will allow a holistic assessment of patients' health and well-being, which can have important implications for the effectiveness of treatment.

Source: https://euclinicaltrials.eu/ctis-public/view/2024-518670-13-00